EU clinical trial 2023-507461-26-00: Prospective randomized multicenter phase III trial of decitabine and venetoclax administered in combination with all-trans retinoic acid or placebo in patients with acute myeloid leukemia who are ineligible for induction chemotherapy - DECIDER-2 trial
Protocol code: P001516
Sponsor: Medical Center - University Of Freiburg (Hospital/Clinic/Other health care facility). Phase: Therapeutic confirmatory (Phase III). Countries: Germany (ongoing, recruiting).
Therapeutic area(s): Diseases [C] - Neoplasms [C04]
Gender: Female, Male. Age: 18-64 years, 65+ years. Enrolment: 256.
Status: Ongoing, recruiting. Start date (EU): 2022-09-22. Decision date: 2024-10-16. Results received: No. Last updated: 2026-07-29.

Condition(s): Newly diagnosed acute myeloid leukemia (AML)
Product: P-Tabletten weiß 7 mm Lichtenstein, Vesanoid 10 mg Kapseln

Primary endpoint: Overall survival (OS) time
Endpoint(s): Objective best response (CR, CRi, MLFS or PR), CR with negative MRD (CRMRD-), OS time with objective best response (CR, CRi, MLFS or PR), Quality of life (EORTC QLQ-C30) (especially fatigue) and FACIT Fatigue Scale

Source: https://euclinicaltrials.eu/ctis-public/view/2023-507461-26-00